EU clinical trial 2024-516108-41-00: CompARE: Phase III randomised controlled trial Comparing Alternative Regimens for escalating treatment of intermediate and high-risk oropharyngeal cancer
Protocol code: RG_14-093
Sponsor: The University Of Birmingham (Educational Institution). Phase: Therapeutic confirmatory (Phase III). Countries: Ireland (ongoing, recruitment ended).
Therapeutic area(s): Diseases [C] - Neoplasms [C04]
Gender: Female, Male. Age: 18-64 years, 65+ years. Enrolment: 24.
Status: Ongoing, recruitment ended. Start date (EU): 2024-12-09. Decision date: 2024-10-29. Results received: No. Last updated: 2026-06-08.

Condition(s): Oropharyngeal cancer
Product: DURVALUMAB, CARBOPLATIN, CISPLATIN

Primary endpoint: 1. Definitive (efficacy) endpoint: Overall Survival (OS) time, 2. Interim outcome measure (activity stages): Event Free Survival (EFS) time
Endpoint(s): 1. Total number of acute (<3 months post-treatment) and late (up to 2 years) severe (grade 3-5) toxicity events at 2 years post randomisation, measured by Common Terminology Criteria for Adverse Events (CTCAE) version 4.0 and version 3.0 for scoring mucositis. Radiation Therapy Oncology Group (RTOG) Radiation Morbidity Scoring Criteria will be used to grade late side effects due to radiotherapy, 2. Overall and head and neck specific QoL at 2 years post randomisation, using the European Organisation for Research and Treatment of Cancer (EORTC) C30 and H&N35 Questionnaires, 3. Swallowing outcomes using M.D. Anderson Dysphagia Inventory (MDADI) Questionnaire at 24 months and percutaneous endoscopic gastrostomy (PEG) utilisation rates at 1 year, 4. Cost effectiveness using EuroQol Group (EQ-5D) and primary and secondary resource utilisation data, 5. Surgical complication rates in each arm, Translation Research Outcome Measures: 1. To determine tumour phenotype correlation with treatment response by molecular analyses, Translational Research Outcome Measures: 2. To develop validation of a patient stratification classifier using markers of proliferation, p53 and related pathways, apoptotic markers, hypoxia and DNA damage response and other genomic and mRNA and circulating DNA markers, Translational Research Outcome Measures: 3. To correlate OS and EFS with Programmed cell death ligand 1 (PD-L1) expression and treatment with durvalumab

Source: https://euclinicaltrials.eu/ctis-public/view/2024-516108-41-00